EU clinical trial 2024-518757-42-00: A multi-centre, randomised, single-blind Phase I/IIa study to evaluate the safety, tolerability and efficacy of a single topical dose of allogeneic integrin α10β1-selected mesenchymal stem cells (XSTEM-VLU) in patients with difficult-to-heal venous leg ulcers
Protocol code: XIN-XSTEM-201
Sponsor: Xintela AB (Pharmaceutical company). Phase: Phase I and Phase II (Integrated)- Other. Countries: Sweden (ended).
Therapeutic area(s): Diseases [C] - Skin and Connective Tissue Diseases [C17]
Gender: Female, Male. Age: 18-64 years, 65+ years. Enrolment: 6.
Status: Ended. Start date (EU): 2024-10-28. End date (EU): 2026-02-11. Decision date: 2024-10-28. Results received: No. Last updated: 2025-04-11.

Condition(s): Difficult-to-heal venous leg ulcers

Source: https://euclinicaltrials.eu/ctis-public/view/2024-518757-42-00